EU clinical trial 2022-502877-41-01: A seamless, phase 1b/2 multiple ascending dose/proof of concept study of XTMAB-16 in patients with pulmonary sarcoidosis with or without extrapulmonary manifestations
Protocol code: XTMAB-16-201
Sponsor: Xentria Inc. (Pharmaceutical company). Phase: Phase I and Phase II (Integrated)- Other. Countries: Poland (ongoing, recruiting), Italy (authorised, recruitment pending), Denmark (authorised, recruiting), Spain (authorised, recruiting), Czechia (ongoing, recruiting).
Therapeutic area(s): Diseases [C] - Respiratory Tract Diseases [C08]
Gender: Female, Male. Age: 18-64 years, 65+ years. Enrolment: 24.
Start date (EU): 2025-02-10. Decision date: 2024-09-10. Results received: No. Last updated: 2026-07-20.
Decision dates by country: CZ: 2024-09-11, PL: 2024-09-16, DK: 2024-09-10, ES: 2024-09-10, IT: 2024-09-11

Condition(s): Pulmonary sarcoidosis with or without extrapulmonary manifestations
Product: Prednesol 5mg Tablets, XTMAB-16, Placebo is formulated as 100 mg placebo in a 20 mL vial. The matching placebo has the same formulation as the drug product except it contains no XTMAB-16.

Primary endpoint: Part A Safety Endpoints Rate of Adverse Events (AEs), including Serious Adverse Events (SAEs), Dose Limiting Toxicities (DLTs), and Adverse Events of Special Interests (AESIs) throughout the study duration Endpoints •Pharmacokinetics (PK) profile including o Ctrough o Cmax o Caverage o Area Under the Curve (AUC), Part A •Pharmacodynamics (PD) markers, including: o Angiotensin converting enzyme (ACE) o Soluble IL-2 receptor (sIL 2R) o C-reactive protein (CRP) o Interleukin -1b (IL-1b) o Calcitriol (vitamin D 1, 25) •Occurrence and persistence of anti-drug antibodies (ADA) •Observed reduction in dose of corticosteroid, Part A •Observed change in quality of life (QoL) and Pulmonary endpoints o Mean percent change in forced vital capacity (FVC)% from Baseline to Week 12 o Change in King's Sarcoidosis Questionnaire (KSQ) - Lung Score o KSQ - General Health Status Module o Leicester Cough Questionnaire (LCQ) o Steroid Toxicity Questionnaire (STQ), Part A •Observed DLT, rate of AESI throughout the study duration between dose levels and frequencies, Part B Efficacy Endpoints Proportion of participants who achieve the targeted tapered dose of corticosteroid (prednisone 5 mg/day or equivalent) by Week 12
Endpoint(s): Part A Efficacy Endpoints •Proportion of participants who achieve the targeted tapered dose of corticosteroid (prednisone 5 mg/day or equivalent) by Week 12 •Proportion of participants who achieve at least 50% reduction in dose of corticosteroid by Week 12, Part A Pharmacokinetic Endpoints •Clearance and volume parameters and half-life in the intended patient population •Dose proportionality •Accumulation ratio repeat dosing •Area under the effect-time curve from time 0 (predose) to the last quantifiable effect-concentration time point, t (AUEC 0-t) •Maximum observed effect (Emax, obs) •Time to reach Emax, obs (tEmax, obs), Part A Change in Biomarker Endpoints •Absolute and percent change in biomarkers from Baseline to End of Infusion (EOI), Week 2, 4, 8, and 12 o Interleukin-6 (IL-6) o Soluble Tumor Necrosis Factor a (sTNFa), Part A Immunogenicity Number and percentage of participants by cohort who test positive for XTMAB-16 ADA at Baseline, Week 4, Week 8, and Week 12 and transient & persistent positive status at follow up assessments, Part A Number and percentage of participants by cohort who test positive for XTMAB-16 nAb at Baseline, Week 4, Week 8, and Week 12 and transient & persistent positive status at follow up assessments, Part B Safety Endpoints Rate of Adverse Events (AEs), including Serious Adverse Events (SAEs) throughout the study duration, Part B Efficacy Endpoints •Proportion of participants who achieve at least 50% reduction in dose of corticosteroid by Week 12 •Proportion of patients able to maintain steroid reduction through Week 24, Part B Pharmacokinetic Endpoints • Clearance and volume parameters and half-life in the intended patient population. • First dose and steady-state AUC, Cmax, Ctrough and Caverage., Part B Change in Biomarkers at Baseline to Week 12 and 24 • Absolute and percent change in biomarkers •ACE •Interleukin-6 (IL-6) •Soluble Interleukin-2 Receptor (sIL 2R) •Soluble tumor necrosis factor α(sTNF α) •CRP •Calcitriol (Vitamin D 1, 25) • Interleukin-1b (IL-1b), Part B Immunogenicity • Number and percentage of participants by cohort who test positive for XTMAB-16 ADA at Baseline to Week 24 and transient & persistent positive status at follow up assessments., Part B • Number and percentage of participants by cohort who test positive for XTMAB-16 nAb at Baseline to Week 24 and transient & persistent positive status at follow up assessments

Source: https://euclinicaltrials.eu/ctis-public/view/2022-502877-41-01